EU clinical trial 2025-520884-42-00: MULTICENTER, RANDOMIZED STUDY TO EVALUATE THE EFFICACY OF INDIVIDUALIZATION OF IMMUNOLOGICAL RISK BASED ON SELECTIVE BIOMARKERS (HLA EPLETH DISPARITY AND IFN-γ ELISPOT) TO OPTIMIZE IMMUNOSUPPRESSIVE TREATMENT IN LIVING DONOR KIDNEY TRANSPLANT PATIENTS (BIOIMMUN)
Sponsor: Fundacio Hospital Universitari Vall D’Hebron Institut De Recerca (Laboratory/Research/Testing facility). Phase: Therapeutic use (Phase IV). Countries: Spain (authorised, recruitment pending).
Therapeutic area(s): Phenomena and Processes [G] - Immune system processes [G12]
Gender: Female, Male. Age: 18-64 years, 65+ years. Enrolment: 164.
Status: Authorised, recruitment pending. Decision date: 2025-01-30. Results received: No. Last updated: 2025-01-30.

Condition(s): Kidney Transplant
Product: Prednisona Pensa 5 mg comprimidos EFG, Simulect 20 mg powder for solution for injection or infusion, tacrolimus cinfa 1 mg cápsulas duras EFG, Micofenolato Mofetile Accord 250 mg capsule rigide, Metilprednisolona NORMON 40 mg polvo y disolvente para solución inyectable EFG, TIMOGLOBULINA 5 mg/ml, polvo para solución para perfusión

Primary endpoint: Composite variable evaluated at 2 years of follow-up as a proportion of patients meeting any of the following criteria: loss of renal function, incidence of biopsy-confirmed clinical acute rejection (BPAR), and development of dnDSA.
Endpoint(s): Mortality from any cause at 24 months, Kidney graft loss at 24 months, Incidence and severity of subclinical and chronic rejection (according to protocol biopsies at 3 and 24 months), Incidence of opportunistic infections at 24 months, Incidence of treatment-related metabolic disorders (diabetes mellitus, dyslipidemia, and hypertension) at 24 months f- Incidence of cardiovascular events at 24 months, Incidence of malignancy (cutaneous and noncutaneous cancer) at 24 months, Proportion of patients maintaining treatment according to protocol at the end of the trial, Changes in immune response at 24 months according to biomarkers: - allogeneic response (dn-DSA, ELISPOT IFN-γ d-sp, Memory B cell Elispot, urine cytokines CXCL9 and CXCL10) - transcriptional profile in blood of rejection risk according to the kSORT test - antiviral cellular response against CMV, EBV, VBK viruses; NKG2, Study of economic cost and study of adherence to treatment (using mobile Health application)., Serious adverse reactions (serious adverse events with a possible causal relationship with immunosuppressive treatment).

Source: https://euclinicaltrials.eu/ctis-public/view/2025-520884-42-00